EU clinical trial 2024-513887-25-00: A phase 2, open label, multicenter, single-stage study to evaluate the efficacy of Isatuximab plus Pomalidomide and Dexamethasone (IPd), in patients with AL amyloidosis not in VGPR or better after any previous therapy
Protocol code: IFM 2020-01
Sponsor: Intergroupe Francophone Du Myelome (Patient organisation/association). Phase: Therapeutic exploratory (Phase II). Countries: France (ended).
Therapeutic area(s): Diseases [C] - Immune System Diseases [C20]
Gender: Female, Male. Age: 18-64 years, 65+ years. Enrolment: 30.
Status: Ended. End date (EU): 2026-01-30. Decision date: 2024-11-18. Results received: No. Last updated: 2025-12-19.

Condition(s): AL Amyloidosis
Product: SARCLISA 20mg/mL concentrate for solution for infusion., Imnovid 2 mg hard capsules, Imnovid 1 mg hard capsules, SARCLISA 20mg/mL concentrate for solution for infusion., DECTANCYL 0,5 mg, comprimé, Imnovid 4 mg hard capsules, Neofordex 40 mg tablets

Primary endpoint: VGPR or better (i.e. dFLC < 40 mg/L) assessed using consensus response criteria (Appendix 2) at the end of 6 cycles
Endpoint(s): Overall Hematologic Response Rate (VGPR, CR, modified CR, Low-dFLC response (dFLC < 10 mg/L), iFLC < 10mg/L and PR assessed using consensus criteria (Appendix 2), at the completion of the 1st, 2nd, 4th, 6th, 9th and 12th cycles, Relapse Free Survival in responding population measured from the date of best response, Progression Free Survival measured from the date of inclusion, Organ response rate (OrRR) at 1 year according to current consensus criteria, Overall Survival measured from the date of inclusion, Time to and duration of hematologic and organ responses, Type, frequency, severity (NCI-CTCAE v5.0), drug discontinuation for toxicity or intolerance, dose modification/delay and relationship of adverse events to study treatment., Left ventricular strain assessed by transthoracic echocardiography (TTE) after 6 cycles of IsaPd and at 1 year from start of therapy or 12 cycles of IsaPd, Albumin level and proteinuria assessed by electrophoresis eGFR estimated by CKD epi after 6 cycles of IsaPd and at 1 year from start of therapy or 12 cycles of IsaPd, Health‐related QoL and potential for improvement over the course of the study assessed by the EQ‐5D‐3L patient‐reported outcome questionnaire

Source: https://euclinicaltrials.eu/ctis-public/view/2024-513887-25-00